EU clinical trial 2025-522817-50-00: Comparison of morphine and alfentanil in the emergency treatment of severe acute pain in the pre-hospital setting
Protocol code: 22_RIPH1-08
Sponsor: CHU De Martinique (Hospital/Clinic/Other health care facility). Phase: Therapeutic use (Phase IV). Countries: France (authorised, recruitment pending).
Therapeutic area(s): Health Care [N] - Population Characteristics [N01]; Health Care [N] - Health Care Quality, Access, and Evaluation [N05]; Diseases [C] - Pathological Conditions, Signs and Symptoms [C23]
Gender: Female, Male. Age: 18-64 years, 65+ years. Enrolment: 242.
Status: Authorised, recruitment pending. Decision date: 2025-11-24. Results received: No. Last updated: 2025-11-24.

Condition(s): Severe pain
Product: MORPHINE (CHLORHYDRATE) AGUETTANT 10 mg/mL, solution injectable, RAPIFEN 1 mg (0,5 mg/ml), solution injectable

Primary endpoint: Proportion of patients with a pain level ≤ 3/10 measured on a numerical scale (EN) 15 minutes after the first injection of the analgesic treatment allocated by the randomisation protocol (morphine or alfentanil).
Endpoint(s): Percentage of patients with side effects respiratory, assessed by respiratory rate < 12 cycles/min and/or oxygen saturation < 90% on room air, Percentage of patients with side effects haemodynamic, assessed by systolic blood pressure below 80 mmHg., Percentage of patients with side effects neurological, assessed by WHO sedation scale > S1 (S0 awake / S1 intermittently drowsy, easily awakened / S2 drowsy most of the time, awakened by verbal stimulation / S3 drowsy most of the time, awakened by tactile stimulation) or requiring recourse to naloxone., Percentage of patients with side effects digestive, assessed by the presence of nausea and/or vomiting., Percentage of patients with side effects cutaneous, assessed by the presence of pruritus., Percentage of patients who received additional analgesic and/or sedative treatment during SMUR care after the first injection of morphine or alfentanil (other than paracetamol)., Time (in minutes) between first injection of analgesic and arrival at hospital., Percentage of patients, according to pain type (traumatic or visceral), with a pain level ≤ 3/10 measured using a numerical scale (NS) 15 minutes after the first injection of the analgesic treatment assigned by the randomisation protocol (morphine or alfentanil).

Source: https://euclinicaltrials.eu/ctis-public/view/2025-522817-50-00